EU clinical trial 2023-504799-94-00: Phase 2, Multicenter, Randomized, Double-Blind, Placebo-Controlled Study to Evaluate the Effects of EP262 in Subjects with Chronic Spontaneous Urticaria
Protocol code: EP-262-201
Sponsor: Escient Pharmaceuticals Inc. (Pharmaceutical company). Phase: Therapeutic exploratory (Phase II). Countries: Poland (ended), Germany (ended), Spain (ended), Netherlands (ended).
Therapeutic area(s): Diseases [C] - Skin and Connective Tissue Diseases [C17]
Gender: Female, Male. Age: 18-64 years, 65+ years. Enrolment: 44.
Status: Ended. Start date (EU): 2024-02-20. End date (EU): 2025-03-03. End date: 2025-03-04. Decision date: 2023-12-28. Results received: Yes. Last updated: 2025-02-24.
Decision dates by country: NL: 2024-01-15, ES: 2024-01-11, DE: 2023-12-28, PL: 2024-01-10

Condition(s): Chronic Spontaneous Urticaria
Product: Placebo, EP262, EP262

Primary endpoint: The change in both itch intensity and number of hives.
Endpoint(s): Type, frequency, and severity of side effects related to the treatment., Change in vital signs, electrocardiograms (ECGs), and clinical laboratory parameters., Change in itch intensity., Change in number of hives.

Source: https://euclinicaltrials.eu/ctis-public/view/2023-504799-94-00